EU clinical trial 2023-504727-32-00: A double-blind, randomised, dose-finding trial to assess the efficacy, safety and pharmacokinetics of a single dose of albaconazole versus fluconazole and placebo in the treatment of acute Candida vulvovaginitis
Protocol code: DC13ALB/2/21
Sponsor: Palau Pharma S.L. (Pharmaceutical company). Phase: Therapeutic exploratory (Phase II). Countries: Spain (ended), Poland (ended).
Therapeutic area(s): Diseases [C] - Bacterial Infections and Mycoses [C01]
Gender: Female. Age: 0-17 years, 18-64 years, 65+ years. Enrolment: 702.
Status: Ended. Start date (EU): 2023-09-18. End date (EU): 2025-10-28. Decision date: 2023-09-18. Results received: No. Last updated: 2025-11-21.
Decision dates by country: PL: 2024-09-30, ES: 2023-09-18

Condition(s): Acute vulvovaginal candidiasis
Product: Diflucan 150 mg cápsulas duras., Albaconazole, Albaconazole, Albaconazole, Placebo - Albaconazole, Placebo - Fluconazole, CANADIOL 100 mg cápsulas

Primary endpoint: Percentage of subjects with clinical cure defined as vulvovaginal score sum = 0 at the Final Visit (FV) by treatment group (albaconazole vs. placebo).

Source: https://euclinicaltrials.eu/ctis-public/view/2023-504727-32-00